EU clinical trial 2024-519106-12-00: Phase II, open label, single arm, multicenter study to assess the activity and safety of ALectinib as NE O adjuvant therapy in patients with anaplastic lymphoma kinase positive (ALK+) locally advanced Stage III Non Small Cell Lung Cancer (NSCLC): ALNEO trial-GOIRC-01-2020
Protocol code: ALNEO trial-GOIRC-01
Sponsor: G.O.I.R.C. Gruppo Oncologico Italiano Di Ricerca Clinica (Patient organisation/association). Phase: Therapeutic exploratory (Phase II). Countries: Italy (authorised, recruitment pending).
Therapeutic area(s): Diseases [C] - Neoplasms [C04]
Gender: Female, Male. Age: 18-64 years, 65+ years. Enrolment: 33.
Status: Authorised, recruitment pending. Decision date: 2024-12-02. Results received: No. Last updated: 2026-06-03.

Condition(s): Patients with anaplastic lymphoma kinase positive (ALK+) locally advanced Stage III Non Small Cell Lung Cancer (NSCLC)
Product: ALECTINIB

Primary endpoint: The primary endpoint is m ajor pathologic response (MPR), defined as <=10% residual viable tumor cells histologically detected in the resected primary tumor and all resected lymph nodes after surgery
Endpoint(s): Pathological complete response - Pathological complete response (pCR) is defined as the absence of residual viable tumor cells in all specimens as evaluated by BIPR after surgery

Source: https://euclinicaltrials.eu/ctis-public/view/2024-519106-12-00